EU clinical trial 2024-516772-15-00: A Study to Assess Adverse Events, and How Intravenously (IV) Infused ABBV-969 Moves Through the Bodies of Adult Participants With Metastatic Castration-Resistant Prostate Cancer
Protocol code: M24-742
Sponsor: AbbVie Deutschland GmbH & Co. KG (Pharmaceutical company). Phase: Human Pharmacology (Phase I)- First administration to humans. Countries: France (ongoing, recruiting), Spain (ongoing, recruiting), Ireland (authorised, recruitment pending).
Therapeutic area(s): Diseases [C] - Neoplasms [C04]
Gender: Male. Age: 18-64 years, 65+ years. Enrolment: 74.
Start date (EU): 2025-08-29. Decision date: 2025-05-23. Results received: No. Last updated: 2026-07-24.
Decision dates by country: ES: 2025-05-27, IE: 2026-07-24, FR: 2025-05-23

Condition(s): Metastatic Castration-Resistant Prostate Cancer, Prostate Cancer

Source: https://euclinicaltrials.eu/ctis-public/view/2024-516772-15-00